EU clinical trial 2024-511357-22-00: A Phase 2 multicentre, randomised, parallel-arm, placebo-controlled, double-blind study to evaluate the safety and target engagement of EXL01 in the prevention of post-operative recurrence of Crohn’s Disease
Protocol code: REMIND-2024-001
Sponsor: Groupe De Recherche Sur Les Maladies Inflammatoires Digestives (Laboratory/Research/Testing facility). Phase: Therapeutic exploratory (Phase II). Countries: France (ongoing, recruiting).
Therapeutic area(s): Diseases [C] - Digestive System Diseases [C06]
Gender: Female, Male. Age: 18-64 years, 65+ years. Enrolment: 80.
Status: Ongoing, recruiting. Start date (EU): 2025-03-31. Decision date: 2025-01-20. Results received: No. Last updated: 2026-06-03.

Condition(s): Crohn's disease
Product: EXL01 matching Placebo, EXL01

Primary endpoint: The distribution of modified Rutgeerts score grouped in 4 categories (i0, i1 - i2a, i2b, i3 - i4) at Week 24/EOT, evaluated by endoscopy with video capture, and assessed by BICR
Endpoint(s): Severe endoscopic recurrence at Week 24/EOT, defined as mRSI equal to i3 or i4, evaluated by endoscopy with video capture, and assessed by BICR., Time to clinical relapse, defined as the time from the first dose of study treatment to first documented clinical relapse (confirmed by endoscopy or imaging procedure and assessed by BICR) The analysis will include all randomised participants as randomised who have a confirmed clinical relapse, regardless of whether the participant withdraws from therapy., Mean values and changed from baseline at Weeks 4, 12 and 24/EOT: • Crohn’s Disease Activity Index (CDAI) overall score • 2-item Patient-Reported Outcome Measure (PRO-2) overall score and subscale scores (stool frequency, abdominal pain, rectal bleeding) • Serum C-reactive protein (CRP) levels • Faecal calprotectin levels, SES-CD score (global score and score per GI segment) at Week 24/EOT, evaluated by endoscopy with video capture, and assessed by BICR., RHI score and Geboes score, at Week 24/EOT, evaluated from histopathology images, marked to identify the segment biopsied and assessed by BICR, . 16S sequencing / shotgun metagenomics in faecal samples at various timepoints . 16S sequencing / shotgun metagenomics in tissue samples at Week 24/EOT . Levels, abundance and change from baseline in F. prausnitzii in faecal samples at various timepoints using qPCR/ddPCR . Levels of F. prausnitzii in biopsy samples at Week 24/EOT, using F. prausnitzii specific qPCR/ddPCR, Mean scores and change from baseline overtime in: . SF-36 overall score and 8 health domain scores . IBDQ overall score and subscale scores (bowel symptoms, systemic symptoms, emotional function, and social function), Endoscopic remission of CD at Week 24/EOT, defined as mRSI = i0, evaluated by endoscopy with video capture and assessed by BICR., . AEs (incidence and severity) . Discontinuing study treatment due to an AE, Endoscopic recurrence at Week 24/EOT, defined as a modified Rutgeerts score equal or superior to i2b (mRSI ≥ i2b), evaluated by endoscopy with video capture, and assessed by BICR

Source: https://euclinicaltrials.eu/ctis-public/view/2024-511357-22-00